EU clinical trial 2023-504383-42-00: A trial in patients suffering from a specific form of an eye disorder called retinitis pigmentosa
Protocol code: VG901-2021 A
Sponsor: ViGeneron GmbH (Pharmaceutical company). Phase: Phase I and Phase II (Integrated)- First administration to humans. Countries: Germany (ongoing, recruiting).
Therapeutic area(s): Diseases [C] - Eye Diseases [C11]
Gender: Female, Male. Age: 18-64 years. Enrolment: 6.
Status: Ongoing, recruiting. Start date (EU): 2025-02-02. Decision date: 2023-06-29. Results received: No. Last updated: 2026-04-09.
Decision dates by country: DE: 2023-07-04

Condition(s): Retinitis Pigmentosa (due to CNGA1 mutation)

Source: https://euclinicaltrials.eu/ctis-public/view/2023-504383-42-00